EU clinical trial 2024-511397-70-00: Phase II study of axitinib intensification plus standard of care (SOC) compared to SOC alone after induction with nivolumab plus ipilimumab in mRCC patients without previous complete response (AxIn study).
Protocol code: AxIn
Sponsor: Consorzio Oncotech (Pharmaceutical company). Phase: Therapeutic exploratory (Phase II). Countries: Italy (ongoing, recruiting), Spain (ongoing, recruiting).
Therapeutic area(s): Diseases [C] - Neoplasms [C04]
Gender: Female, Male. Age: 18-64 years, 65+ years. Enrolment: 178.
Status: Ongoing, recruiting. Start date (EU): 2024-05-06. Decision date: 2024-03-15. Results received: No. Last updated: 2026-04-22.
Decision dates by country: IT: 2024-03-15, ES: 2025-08-08

Condition(s): metastatic renal cell carcinoma (mRCC)
Product: AXITINIB

Primary endpoint: • To evaluate the overall response rate in patients treated with the axitinib in addiction to SOC compared to SOC alone.
Endpoint(s): • To evaluate the efficacy of axitinib in addiction to SOC compared to SOC alone in terms of: a) Progression free survival b) Overall survival c) Depth of response d) Duration of response e) Quality of life • To evaluate the safety of axitinib in addiction to SOC compared to SOC alone

Source: https://euclinicaltrials.eu/ctis-public/view/2024-511397-70-00